EU clinical trial 2022-501325-20-00: Comparative Bioavailability of Nilotinib 200 mg Hard Capsules: A Single-Dose, Open-Label, Randomized, Four-Sequence, Four-Treatment, Four-Period Crossover Pilot Study in Healthy Subjects.
Protocol code: BLCL-NIL-PIL03
Sponsor: Bluepharma Industria Farmaceutica S.A. (Pharmaceutical company). Phase: Human Pharmacology (Phase I)- Bioequivalence Study. Countries: Portugal (ended).
Therapeutic area(s): Diseases [C] - Neoplasms [C04]
Gender: Female, Male. Age: 18-64 years. Enrolment: 20.
Status: Ended. Start date (EU): 2022-10-06. End date (EU): 2022-11-11. Decision date: 2022-10-03. Results received: Yes. Last updated: 2022-10-03.

Condition(s): Primary Philadelphia-chromosome positive leukemia cells from chronic myelogenous leukemia (CML)
Product: Nilotinib, Tasigna 200 mg hard capsules, Nilotinib, Nilotinib

Primary endpoint: The following pharmacokinetic endpoints will be estimated: Cmax; tmax; AUC) from pre-dose (time zero) to the last sampling time with quantifiable concentrations (AUC0-t); AUC from time zero to infinity (AUC0-∞); residual area or percentage of extrapolated part of AUC0-∞ (%AUCextrap); λz; and t1/2.
Endpoint(s): Safety will be evaluated through the assessment of adverse events (AEs), ECG, vital signs, and clinical laboratory tests.

Source: https://euclinicaltrials.eu/ctis-public/view/2022-501325-20-00